EU clinical trial 2025-522400-24-00: IZABRIGHT-BLADDER01: A Randomized, Open-label, Phase 2/3 trial of Izalontamab Brengitecan versus platinum-based chemotherapy for metastatic urothelial cancer in participants with disease progression on or after an immunotherapy-based treatment
Protocol code: CA2440012
Sponsor: Bristol-Myers Squibb Services Unlimited Company (Pharmaceutical company). Phase: Phase II and Phase III (Integrated). Countries: Ireland (ongoing, recruiting), Belgium (ongoing, recruiting), Germany (ongoing, recruiting), Italy (ongoing, recruiting), Norway (ongoing, recruiting), Spain (ongoing, recruiting), Austria (ongoing, recruiting), Sweden (ongoing, recruiting), France (ongoing, recruiting), Romania (ongoing, recruiting), Czechia (authorised, recruitment pending).
Therapeutic area(s): Diseases [C] - Female Urogenital Diseases and Pregnancy Complications [C13]; Diseases [C] - Male Urogenital Diseases [C12]
Gender: Female, Male. Age: 18-64 years, 65+ years. Enrolment: 207.
Start date (EU): 2026-01-27. Decision date: 2025-12-19. Results received: No. Last updated: 2026-04-24.
Decision dates by country: ES: 2026-01-09, CZ: 2026-04-21, AT: 2025-12-22, FR: 2025-12-23, IT: 2025-12-23, BE: 2025-12-22, IE: 2026-01-09, NO: 2025-12-19, SE: 2026-03-05, RO: 2026-01-08, DE: 2026-03-04

Condition(s): Metastatic urothelial cancer
Product: CISPLATIN, BL-B01D1, GEMCITABINE, PEGFILGRASTIM, CARBOPLATIN

Primary endpoint: Phase 2: Will be assessed by reviewing all available data, including efficacy, safety, tolerability, and pharmacokinetic data., Phase 3: Efficacy will be evaluated by comparing progression-free survival (time from start of treatment until worsening of disease or death, whichever comes first) and overall survival (how long a patient lives) between iza-bren and PBC.
Endpoint(s): Phase 2 and 3: Additional efficacy endpoints will be tested in both groups of patients, including what proportion of participants respond to treatment (objective response rate), how long until participants respond to treatment (time to response), how long a participants’ response to treatment lasts (duration of response), time without cancer growing (progression free survival) and how long patients survive (overall survival)., In Phase 3 only, the time it takes for participants to report a decline in their quality of life will be measured and compared.

Source: https://euclinicaltrials.eu/ctis-public/view/2025-522400-24-00